EU clinical trial 2022-502658-15-00: A Phase 3, Randomized, Double-blind Study of Neoadjuvant Chemotherapy plus Nivolumab versus Neoadjuvant Chemotherapy plus Placebo, followed by Surgical Resection and Adjuvant Treatment with Nivolumab or Placebo for Participants with Resectable Stage II-IIIB Non-small Cell Lung Cancer (CheckMate 77T, CHECKpoint pathway and nivoluMAb clinical Trial Evaluation 77T)
Protocol code: CA209-77T
Sponsor: Bristol-Myers Squibb Services Unlimited Company (Pharmaceutical company). Phase: Therapeutic confirmatory (Phase III). Countries: Netherlands (ongoing, recruitment ended), Czechia (ongoing, recruitment ended), Spain (ongoing, recruitment ended), Germany (ongoing, recruitment ended), Italy (ongoing, recruitment ended), Romania (ongoing, recruitment ended), Belgium (ongoing, recruitment ended), France (ongoing, recruitment ended), Poland (ongoing, recruitment ended).
Therapeutic area(s): Diseases [C] - Neoplasms [C04]
Gender: Female, Male. Age: 18-64 years, 65+ years. Enrolment: 252.
Status: Ongoing, recruitment ended. Start date (EU): 2019-09-22. Decision date: 2023-07-24. Results received: No. Last updated: 2026-07-21.
Decision dates by country: NL: 2023-07-24, FR: 2023-07-27, RO: 2023-07-27, PL: 2023-07-31, ES: 2023-07-24, DE: 2023-07-25, CZ: 2023-07-25, BE: 2023-07-27, IT: 2023-07-26

Condition(s): Resectable Stage II-IIIB Non-small cell lung cancer
Product: Paclitaxel-GRY® 6 mg/ml Konzentrat zur Herstellung einer Infusionslösung, ALIMTA 500 mg powder for concentrate for solution for infusion, Doce NC 10 mg/ml Konzentrat zur Herstellung einer Infusionslösung, TAXOL 6 mg/ml, concentrato per soluzione per infusione., Cisplatin-Ebewe, 1 mg/ml, koncentrat do sporządzania roztworu do infuzji, Bendatax 6 mg/ ml, Carboplatin Bendalis 10mg/ml, Konzentrat zur Herstellung einer Infusionslösung, Paclitaxel Aurobindo 6 mg/ml Konzentrat zur Herstellung einer Infusionslösung, Cisplatin Teva® 1 mg/ml Konzentrat zur Herstellung einer Infusionslösung, OPDIVO 10 mg/mL concentrate for solution for infusion., 0.9% Sodium Chloride Solution for Injection, CARBO-cell® 10 mg/ml Infusionslösung, Konzentrat zur Herstellung einer Infusionslösung Carboplatin, Cisplatin NeoCorp 1 mg/ml - Konzentrat zur Herstellung einer Infusionslösung, Carbomedac® 10 mg/ml Konzentrat zur Herstellung einer Infusionslösung, 5% Dextrose Solution for Injection, Docetaxel-Ebewe, 10 mg/ml, koncentrat do sporządzania roztworu do infuzji

Primary endpoint: Event-Free Survival (EFS) as Assessed by Blinded Independent Central Review (BICR)
Endpoint(s): Overall Survival (OS), Pathologic Complete Response (pCR) Rate as Assessed by Blinded Independent Pathology Review (BIPR), Major Pathological Response (MPR) Rate as Assessed by Blinded Independent Pathology Review, Incidence of Serious Adverse Events (SAEs), Incidence of Adverse Events (AEs)

Source: https://euclinicaltrials.eu/ctis-public/view/2022-502658-15-00